EU clinical trial 2022-502254-13-00: Metastasis-directed therapy in oligoprogressive castration-refractory prostate cancer: a randomized phase 3 trial
Protocol code: S67130
Sponsor: UZ Leuven (Hospital/Clinic/Other health care facility). Phase: Therapeutic confirmatory (Phase III). Countries: Belgium (ongoing, recruiting).
Therapeutic area(s): Diseases [C] - Male Urogenital Diseases [C12]
Gender: Male. Age: 18-64 years, 65+ years. Enrolment: 246.
Status: Ongoing, recruiting. Start date (EU): 2023-12-18. Decision date: 2023-04-11. Results received: No. Last updated: 2025-07-18.

Condition(s): Oligoprogressive metastatic castration-refractory prostate cancer
Product: NUBEQA 300 mg film-coated tablets, Talzenna 0.25 mg hard capsules, TAXOTERE 20 mg/1 ml concentrate for solution for infusion, 177Lu PSMA I&T solution for injection, Lynparza 150 mg film-coated tablets, Xofigo 1100 kBq/mL solution for injection, Xtandi - 40 mg film-coated tablets, ZYTIGA 500 mg film-coated tablets, JEVTANA 60 mg concentrate and solvent for solution for infusion, Erleada 60 mg film-coated tablets, Akeega 100 mg/500 mg film-coated tablets

Primary endpoint: Overall survival (OS) will be calculated from the day of randomization until death from any cause.
Endpoint(s): Quality of life (QOL): Quality of life scoring using the EORTC QLQ-C30 supplement with QLQ-PR25. We will assess the quality-of-life-years with the EuroQOL classification system (EQ-5D-5L). Assessments are planned at baseline and during follow-up consultation at month M1, M3, M6, M12 and M24., Cancer specific survival: Cancer specific survival (CSS) will be calculated from the day of randomization until PCa death., Radiographic progression free survival: Radiographic progression free survival will be calculated from the day of randomization until the first day of progression (local, nodal or metastatic) on conventional imaging or PSMA PET-CT. rPFS will be determined using the same imaging modality employed at baseline. Imaging is performed every 6 months during follow-up or at any time in case of PSA progression or symptoms., Metastasis-directed therapy induced acute and late toxicity scoring: Acute and late toxicity as a result of radiotherapy will be scored using the Common Toxicity Criteria Version 5.0 (21). Toxicity will be scored at every follow-up visit., Cost-effectiveness of metastasis-directed therapy in patients with oligoprogressive metastatic castration-refractory prostate cancer., 18F PSMA PET-CT prediciton value in patients with oligoprogressive metastatic castration-refractory prostate cancer.

Source: https://euclinicaltrials.eu/ctis-public/view/2022-502254-13-00